EU clinical trial 2022-502788-39-00: Randomised study for double-blind, placebo-controlled evaluation of BI 765845 on top of standard of care in patients with myocardial infarction
Protocol code: 1478-0002
Sponsor: Boehringer Ingelheim International GmbH, Boehringer Ingelheim RCV GmbH & Co. KG, Boehringer Ingelheim Espana S.A. (Pharmaceutical company). Phase: Therapeutic exploratory (Phase II). Countries: Slovakia (ended), Poland (ended), Germany (ended), Czechia (ended), Hungary (ended), Italy (ended), Spain (ended).
Therapeutic area(s): Diseases [C] - Cardiovascular Diseases [C14]
Gender: Female, Male. Age: 18-64 years, 65+ years. Enrolment: 194.
Status: Ended. Start date (EU): 2023-11-27. End date (EU): 2025-11-11. End date: 2025-12-02. Decision date: 2023-10-30. Results received: No. Last updated: 2025-08-06.
Decision dates by country: SK: 2023-10-30, ES: 2023-11-02, CZ: 2023-11-01, HU: 2023-10-30, DE: 2023-10-30, PL: 2023-11-02, IT: 2023-10-31

Condition(s): acute myocardial infarction
Product: Placebo matching BI 765845, BI 765845, Gadovist 1.0 mmol/ml solution for injection

Primary endpoint: Infarct severity

Source: https://euclinicaltrials.eu/ctis-public/view/2022-502788-39-00